EU clinical trial 2024-515070-28-00: A Phase 3b, open label, randomized, standard-of-care control arm, multicenter, superiority study evaluating the efficacy, safety and tolerability of injectable CAB LA + RPV LA in viremic participants living with HIV-1 (CROWN)
Protocol code: 221611
Sponsor: Viiv Healthcare UK Limited (Pharmaceutical company). Phase: Therapeutic confirmatory (Phase III). Countries: Spain (ongoing, recruitment ended), Belgium (ongoing, recruitment ended), Germany (ongoing, recruitment ended), Italy (ongoing, recruitment ended), Portugal (ongoing, recruiting).
Therapeutic area(s): Diseases [C] - Virus Diseases [C02]
Gender: Female, Male. Age: 0-17 years, 18-64 years, 65+ years. Enrolment: 98.
Start date (EU): 2024-12-23. Decision date: 2024-12-18. Results received: No. Last updated: 2026-06-10.
Decision dates by country: DE: 2025-09-22, ES: 2024-12-18, PT: 2025-08-07, IT: 2025-09-17, BE: 2025-09-22

Condition(s): HIV Infections
Product: Vocabria 600 mg prolonged-release suspension for injection, REKAMBYS 900 mg prolonged-release suspension for injection

Primary endpoint: Virologic response (HIV 1 RNA <50 c/mL) using the Snapshot Algorithm at Month 6
Endpoint(s): Time to virologic suppression (HIV-1 RNA <50 c/mL) from baseline (Day 1) through Month 6, Time to TRDF (PDVF or drug-related AE, intolerability of injections, protocol defined stopping criteria or lack of efficacy) from baseline (Day 1) through Month 6, Protocol-defined VF through Month 6, Occurrence of developing RAMs through Month 6, Occurrence of developing INSTI or NNRTI RAMs through Months 12 and 24

Source: https://euclinicaltrials.eu/ctis-public/view/2024-515070-28-00